EU clinical trial 2022-502075-34-00: An open-label Extension study to evaluate rozanolixizumab in pediatric study participants with generalized myasthenia gravis
Protocol code: MG0008
Sponsor: UCB Biopharma (Pharmaceutical company). Phase: Therapeutic confirmatory (Phase III). Countries: Poland (ongoing, recruitment ended), Italy (ongoing, recruitment ended).
Therapeutic area(s): Diseases [C] - Nervous System Diseases [C10]
Gender: Female, Male. Age: 0-17 years, 18-64 years. Enrolment: 7.
Status: Ongoing, recruitment ended. Start date (EU): 2024-10-08. Decision date: 2024-02-09. Results received: No. Last updated: 2026-02-11.
Decision dates by country: PL: 2024-02-09, IT: 2024-04-17

Condition(s): Generalized Myasthenia Gravis
Product: Rozanolixizumab

Primary endpoint: - Occurrence of serious Treatment-Emergent Adverse Events (TEAEs) up to the End of Study (EOS) Visit - Occurrence of TEAEs leading to permanent withdrawal of IMP up to the EOS Visit - Occurrence of Adverse Event(s) of Special Monitoring (AESM) up to the EOS Visit
Endpoint(s): - Percent change in total Immunoglobulin G (IgG) from Baseline to the end of Week 6 of each Treatment Period (TP) - Absolute change in total IgG from Baseline to the end of Week 6 of each TP - Change from Baseline in Myasthenia Gravis-Activities of Daily Living (MG ADL) total score at the end of Week 6 of each TP - Change from Baseline in Quantitative Myasthenia Gravis (QMG) total score at the end of Week 6 of each TP

Source: https://euclinicaltrials.eu/ctis-public/view/2022-502075-34-00